EU clinical trial 2024-514629-52-00: A clinical study of MK-1403 in healthy men (MK-1403-004)
Protocol code: MK-1403-004
Sponsor: Merck Sharp & Dohme LLC (Pharmaceutical company). Phase: Human Pharmacology (Phase I)- Other. Countries: Belgium (ended).
Therapeutic area(s): Diseases [C] - Cardiovascular Diseases [C14]
Gender: Male. Age: 18-64 years. Enrolment: 32.
Status: Ended. Start date (EU): 2024-10-28. End date (EU): 2025-07-17. End date: 2025-07-18. Decision date: 2024-10-15. Results received: No. Last updated: 2025-04-24.

Condition(s): Atherosclerosis

Source: https://euclinicaltrials.eu/ctis-public/view/2024-514629-52-00